EU clinical trial 2025-520913-29-00: (CO2MO) A prospective, multicenter clinical performance study to evaluate IOpener®-melanoma test for predicting response to combination or mono immunotherapy in stage III or IV cutaneous melanoma patients.
Protocol code: CO2MO
Sponsor: Leids Universitair Medisch Centrum (LUMC) (Hospital/Clinic/Other health care facility). Phase: Therapeutic use (Phase IV). Countries: Netherlands (ongoing, recruiting).
Therapeutic area(s): Analytical, Diagnostic and Therapeutic Techniques and Equipment [E] - Diagnosis [E01]
Gender: Female, Male. Age: 18-64 years, 65+ years. Enrolment: 96.
Status: Ongoing, recruiting. Start date (EU): 2026-01-14. Decision date: 2025-07-25. Results received: No. Last updated: 2025-07-25.

Condition(s): Melanoma
Product: PEMBROLIZUMAB, NIVOLUMAB, IPILIMUMAB

Primary endpoint: • 1-Year PFS (proportion of patients with Progression Free Survival ^ 1 year)
Endpoint(s): Disease Control Rate (DCR, "clinical benefit”), based on Best Overall Response according to RECIST 1.1, overal response Rate (ORR) based on Best Overall Response according tot RECIST 1.1, overall survival (OS) and progression free survial (PFS), Quality of Life (QoL) using EQ-5D-5L, Medical Costs

Source: https://euclinicaltrials.eu/ctis-public/view/2025-520913-29-00